EU clinical trial 2023-509488-26-00: A study to learn how asundexian affects the amount of metformin in the blood when healthy participants take them together
Protocol code: 22375
Sponsor: Bayer AG (Pharmaceutical company). Phase: Human Pharmacology (Phase I)- Other. Countries: Germany (ended).
Therapeutic area(s): Diseases [C] - Cardiovascular Diseases [C14]
Gender: Female, Male. Age: 18-64 years. Enrolment: 16.
Status: Ended. Start date (EU): 2024-07-18. End date (EU): 2024-08-20. Decision date: 2024-05-31. Results received: No. Last updated: 2024-05-31.

Condition(s): Prevention of ischemic stroke in patients after an acute non-cardioembolic ischemic stroke or high-risk transient ischemic attack in combination with antiplatelet therapy

Source: https://euclinicaltrials.eu/ctis-public/view/2023-509488-26-00